EU clinical trial 2024-519591-39-00: Randomized phase 2 study of Simvastatin in patients with ARID1A mutated advanced gastrooesophageal carcinoma treated with Nivolumab and Oxaliplatin-based chemotherapy as first-line treatment (The ARES trial).
Sponsor: IRCCS Istituto Nazionale Tumori Fondazione Pascale (Hospital/Clinic/Other health care facility). Phase: Therapeutic exploratory (Phase II). Countries: Italy (authorised, recruiting).
Therapeutic area(s): Diseases [C] - Digestive System Diseases [C06]; Diseases [C] - Neoplasms [C04]
Gender: Female, Male. Age: 18-64 years, 65+ years. Enrolment: 84.
Status: Authorised, recruiting. Start date (EU): 2025-11-11. Decision date: 2025-06-04. Results received: No. Last updated: 2025-06-04.

Condition(s): advanced or metastatic gastrooesophageal carcinoma HER2 negative and ARID1A mutated
Product: OPDIVO 10 mg/mL concentrate for solution for infusion., FLUOROURACIL, Oxaliplatino Sandoz, LEDERFOLIN 175 mg polvere per soluzione per infusione, FLUOROURACIL, SIMVASTATIN, CAPECITABINE

Primary endpoint: PFS 1-year is measured as the time from initiation of study(i.e randomization)to the first documentation of objective disease progression by RECIST 1.1 criteria,including deterioration of clinical conditions preventing radiological restaging, treatment interruption due to AEs followed by initiation of an alternative antineoplastic treatment, or death due to any cause, whichever occurs first in one year.It will be measured as the rate of assessable patients alive and without disease progression
Endpoint(s): Progression free survival (PFS) calculated as the time from randomization until the date of death from any cause until the date of the first observation of disease progression or death due to any cause, as previously defined, whichever occurs first. PFS will be censored at the time of the last available tumor assessment documenting absence of progressive disease for patients alive at the time of analysis., Overall survival (OS) calculated as the time from randomization until the date of death from any cause. OS will be censored at the last date the patient was known to be alive for patients alive at the time of analysis., Objective Tumor Response Rate (ORR) assessed according to RECIST criteria 1.1, as the proportion of patients achieving complete or partial response relative to total enrolled patients., Disease Control Rate (DCR) defined as the proportion of patients with complete/partial response and stable disease as their best response, Overall Toxicity rate defined as adverse events graded according to NCI CTCAE v 5.0. as the proportion of patients experiencing any grade AE accordingly to the NCI Common Terminology Criteria of Adverse Events (NCI CTC-AE) Version 5, relative to the total of patients receiving at least one cycle of treatment.AE will be listed individually by the patient and summarized overall (severity grades 1-4) and for grade ≥3 by treatment received, Quality of life (QoL) investigated through the EORTC QOL-C30 questionnaire at baseline (prior to treatment start, once eligibility is confirmed) and every 12 weeks until disease progression, treatment failure or death., Exploratory Endpoint: For the exploratory objective, we will compare PFS and OS of the standard ARM A with PFS and OS calculated in observational cohort of 28 consecutive aGEC HER2 negative and ARID1A non mutated patients (ARM C) treated with standard first-line combination of nivolumab and oxaliplatin-based chemotherapy regimen.

Source: https://euclinicaltrials.eu/ctis-public/view/2024-519591-39-00